EU clinical trial 2026-526279-52-00: A First‑in‑Human Phase 1 Study to Investigate the Safety, Tolerability, and PK of AB102 in Healthy Participants
Protocol code: ARC-102-101
Sponsor: Arcus Biosciences Inc. (Pharmaceutical company). Phase: Human Pharmacology (Phase I)- First administration to humans. Countries: Netherlands (ongoing, recruiting).
Therapeutic area(s): Diseases [C] - Skin and Connective Tissue Diseases [C17]
Gender: Female, Male. Age: 18-64 years. Enrolment: 130.
Status: Ongoing, recruiting. Start date (EU): 2026-06-26. Decision date: 2026-06-16. Results received: No. Last updated: 2026-06-16.

Condition(s): Healthy volunteers

Source: https://euclinicaltrials.eu/ctis-public/view/2026-526279-52-00